EU clinical trial 2024-510703-11-00: InTTercePT : Treatment with Tucatinib in addition to Pertuzumab and Trastuzumab in patients with HER2-positive metastatic breast cancer after local therapy of isolated brain progression
Protocol code: UC-BCG-2011
Sponsor: Unicancer (Hospital/Clinic/Other health care facility). Phase: Therapeutic exploratory (Phase II). Countries: France (ongoing, recruitment ended).
Therapeutic area(s): Diseases [C] - Neoplasms [C04]
Gender: Female, Male. Age: 18-64 years, 65+ years. Enrolment: 55.
Status: Ongoing, recruitment ended. Start date (EU): 2021-12-13. Decision date: 2024-03-19. Results received: No. Last updated: 2026-01-12.

Condition(s): HER2+ metastatic breast cancer with isolated brain progression
Product: TRASTUZUMAB, FULVESTRANT, EXEMESTANE, PERTUZUMAB, PERTUZUMAB, TRASTUZUMAB, PERTUZUMAB, TUKYSA 150 mg film-coated tablets, LETROZOLE, TUKYSA 50 mg film-coated tablets, TRASTUZUMAB, ANASTROZOLE

Primary endpoint: 6-month Progression-Free Survival (PFS) rate, defined as the proportion of patients with an objective tumor progression by imaging, or death from any cause, whichever occurs first at 6 months from inclusion.
Endpoint(s): Efficacy : Overall Survival (OS) defined as the time interval between the date of inclusion in the study and the date of death (all causes). Patients not known to have died at the time of analysis will be censored at the last recorded date on which the patient was known to be alive., Efficacy : Brain Progression-Free Survival (BPFS) defined as the time interval between the date of inclusion in the study and the date of documented progression of the brain metastases. Tumor progression will be evaluated according to RECIST v1.1, as determined by investigator assessment, or as the appearance of a lesion for patients in complete response (CR) at the brain level at the inclusion., Efficacy : In patients who are not in CR at the brain level after local treatment: Overall brain metastasis response defined as the best overall response of the brain metastases during the study., Safety : Adverse Events will be graded according to National Cancer Institute-common terminology criteria for adverse events (NCI-CTCAE) v5.0., Ancillary studies : Biomarkers research will be defined by the study steering committee at the end of the trial to ensure the optimal use of update technologies and hypotheses.

Source: https://euclinicaltrials.eu/ctis-public/view/2024-510703-11-00